EU clinical trial 2025-523214-83-00: The effect of transdermal 17-β-estradiol/progesterone supplementation on glucose regulation in peri- and postmenopausal women with type 1 and type 2 diabetes
Sponsor: Amsterdam UMC Stichting (Patient organisation/association). Phase: Therapeutic use (Phase IV). Countries: Netherlands (ongoing, recruiting).
Therapeutic area(s): Diseases [C] - Hormonal diseases [C19]; Phenomena and Processes [G] - Physiological processes [G07]
Gender: Female. Age: 18-64 years. Enrolment: 48.
Status: Ongoing, recruiting. Start date (EU): 2026-02-09. Decision date: 2025-12-15. Results received: No. Last updated: 2025-12-15.

Condition(s): Diabetes Mellitus, (peri) Menopause
Product: Systen 50, pleisters voor transdermaal gebruik 50 microgram/24 uur, Utrogestan, capsules

Primary endpoint: The main endpoint is the difference in the 14-day glucose time-in-range (TIR) during the final two weeks of treatment with estradiol/progesterone compared to the control period.
Endpoint(s): Glucose regulation parameters: change in time-below –range (TBR, %), time-above-range (TAR, %), glycaemic variability (coefficient of variation [CV]), and mean glucose measured using 14 days of blinded CGM after 12 weeks of estradiol/progesterone versus 12 weeks of no intervention., Change in serum HbA1c, carbohydrate-insulin ratio (CIR), daily insulin dose, Insulin sensitivity (whole body and adipose tissue) measured by hyperinsulinemiceuglycemic clamp. Whole body insulin sensitivity will be expressed as the ratio of M – value and insulin concentration: M / I. M – value in mg / kg / min and I in uIU/uL. Adipose tissue insulin sensitivity will be expressed as the suppression of plasma free fatty acid concentration in %., Cardiovascular risk: change in lipid profile and 24-hour blood pressure, Change in liver steatosis using the CAP score assessed with fibroscan and for participants with T2DM total liver fat assessed with MRI-PDFF, Change in handgrip strength using handgrip dynamometry, Change in climacteric symptoms (Greene Climacteric Scale questionnaire), quality of sleep (Insomnia severity index), depressive symptoms (Hospital Anxiety and Depression Score), diabetes distress (Problem Areas In Diabetes), and quality of life (WHO-5).

Source: https://euclinicaltrials.eu/ctis-public/view/2025-523214-83-00